EU clinical trial 2024-518349-85-01: BALLAD Belgium - A trial to evaluate the potential benefit of adjuvant chemotherapy for small bowel adenocarcinoma. The Belgian component of the Global Ballad pooled data analysis.
Protocol code: Ballad Belgium
Sponsor: Groupe Belge D'Oncologie Digestive (Hospital/Clinic/Other health care facility). Phase: Therapeutic confirmatory (Phase III). Countries: Belgium (authorised, recruitment pending).
Therapeutic area(s): Diseases [C] - Neoplasms [C04]
Gender: Female, Male. Age: 18-64 years, 65+ years. Enrolment: 30.
Status: Authorised, recruitment pending. Decision date: 2024-11-20. Results received: No. Last updated: 2024-11-20.

Condition(s): small bowel adenocarcinoma
Product: Fluorouracil Accord Healthcare 50 mg/ml, solution pour injection ou perfusion, ELVORINE 50 mg/5 mL, solution injectable, ELOXATIN 5 mg/ml concentraat voor oplossing voor infusie, Xeloda 150 mg film-coated tablets, ELOXATIN 5 mg/ml concentraat voor oplossing voor infusie, Fluorouracil Accord Healthcare 50 mg/ml oplossing voor injectie of infusie, Fluorouracil Accord Healthcare 50 mg/ml, solution pour injection ou perfusion, Xeloda 500 mg film-coated tablets, Fluorouracil Accord Healthcare 50 mg/ml, solution pour injection ou perfusion, Fluorouracil Accord Healthcare 50 mg/ml, solution pour injection ou perfusion, ELVORINE 25 mg/2,5 mL, solution injectable

Primary endpoint: Disease free survival (defined as time from randomisation to recurrence, development of new primary or death from any cause).
Endpoint(s): Overall survival, toxicity, clinico-pathological, epidemiological and molecular profiling of SBA.

Source: https://euclinicaltrials.eu/ctis-public/view/2024-518349-85-01